EU clinical trial 2024-518644-21-01: An Open-label, Multicenter, Phase 1/2a Study to Investigate the Safety, Tolerability, Pharmacokinetics, and Anti-tumour Activity of WEF-001 in participants with Advanced KRAS- Mutant Solid Tumours.
Protocol code: WEF-001-01
Sponsor: Auricula Biosciences Inc. (Pharmaceutical company). Phase: Phase I and Phase II (Integrated)- Other. Countries: Spain (authorised, recruitment pending).
Therapeutic area(s): Diseases [C] - Neoplasms [C04]
Gender: Female, Male. Age: 18-64 years, 65+ years. Enrolment: 27.
Status: Authorised, recruitment pending. Decision date: 2025-12-09. Results received: No. Last updated: 2026-05-20.

Condition(s): Advanced KRAS- Mutant Solid Tumours
Product: WEF-001

Primary endpoint: Primary Endpoints - Phase 1: 1. Type, incidence and severity of TEAEs, SAEs and abnormal laboratory values per CTCAE v5.0. 2. Frequency of dose interruptions, reductions, and discontinuations. 3. Proportion of participants with DLTs at each dose level., Primary Endpoints - Phase 2a: 1. ORR according to RECIST v 1.1.
Endpoint(s): Secondary Endpoints - Phase 1: 1. PK parameters including, but not limited to a. AUC, b. Cmax, c. Tmax, d. T1/2 e. Clearance, f. Vd. 2. BOR, with calculation of ORR as a sum of CR or PR, and DCR as a sum of CR, PR, or SD, PFS, TTR and DOR according to RECIST v 1.1., Secondary Endpoints - Phase 2a: 1. DCR, DOR, and PFS according to RECIST v 1.1. 2. Type, incidence and severity of TEAEs, SAEs and clinical laboratory abnormalities per CTCAE v5.0. 3. Frequency of dose interruptions, reductions, and discontinuations. 4. PK parameters including, but not limited to a. AUC, b. Cmax, c. Tmax, d. T1/2, e. Clearance, f. Vd.

Source: https://euclinicaltrials.eu/ctis-public/view/2024-518644-21-01